EU clinical trial 2024-514665-19-00: Phase II Open Labeled Trial of Disulfiram with Copper in Metastatic Breast Cancer
Protocol code: 2016-1-DSF-MBC
Sponsor: Univerzita Palackeho V Olomouci (Educational Institution). Phase: Therapeutic exploratory (Phase II). Countries: Czechia (ended).
Therapeutic area(s): Diseases [C] - Neoplasms [C04]
Gender: Female, Male. Age: 18-64 years, 65+ years. Enrolment: 150.
Status: Ended. Start date (EU): 2019-01-29. End date (EU): 2024-09-12. Decision date: 2024-09-12. Results received: Yes. Last updated: 2024-09-12.

Condition(s): metastatic breast cancer
Product: DISULFIRAM

Primary endpoint: effect of treatment with disulfiram and copper on clinical response rate (RR, percentage of patients whose cancer shrinks; termed a partial response, PR; or disappears after treatment; termed a complete response, CR; RR=PR+CR), effect of treatment with disulfiram and copper on clinical benefit rate (CBR=CR+PR+SD, where SD is defined as a stable disease - neither sufficient shrinkage to qualify for PR nor sufficient increase to qualify for PD for minimum 6-8 weeks)
Endpoint(s): Time to progression (TTP), Overall survival (OS), Pharmacokinetic - Total exposure (AUC0-τ), Pharmacokinetic - Maximum plasma concentrations (Cmax), Pharmacokinetic - Minimum plasma concentration (Cmin), Safety outcome measures - Nature, frequency, and severity of adverse events as graded using Common Terminology Criteria for Adverse Events (CTCAE), v5.0

Source: https://euclinicaltrials.eu/ctis-public/view/2024-514665-19-00